EU clinical trial 2022-503046-50-00: The effect of multiple doses of carbamazepine on the pharmacokinetics of a single oral dose of BI 1810631 in healthy male subjects (an open-label, two-period, fixed-sequence crossover trial)
Protocol code: 1479-0011
Sponsor: Boehringer Ingelheim International GmbH (Pharmaceutical company). Phase: Human Pharmacology (Phase I)- Other. Countries: Germany (ended).
Therapeutic area(s): Diseases [C] - Neoplasms [C04]
Gender: Male. Age: 18-64 years. Enrolment: 16.
Status: Ended. Start date (EU): 2023-09-11. End date (EU): 2023-12-08. Decision date: 2023-07-19. Results received: Yes. Last updated: 2023-07-19.

Condition(s): Healthy volunteer trial
Product: Carbamazepin-neuraxpharm 600 mg retard Retardtabletten, Carbamazepin-neuraxpharm 400 mg retard Retardtabletten

Primary endpoint: AUC0-∞ (area under the concentration-time curve of the analyte in plasma over the time interval from 0 extrapolated to infinity), Cmax (maximum measured concentration of the analyte in plasma)
Endpoint(s): AUC0-tz (area under the concentration-time curve of the analyte in plasma over the time interval from 0 to the last quantifiable data point)

Source: https://euclinicaltrials.eu/ctis-public/view/2022-503046-50-00